EU clinical trial 2023-509706-30-00: EASi-HF Preserved – A Phase III double-blind, randomised, parallel-group superiority trial to evaluate efficacy and safety of the combined use of oral vicadrostat (BI 690517) and empagliflozin compared with placebo and empagliflozin in participants with symptomatic heart failure (HF: NYHA II-IV) and left ventricular ejection fraction (LVEF) ≥40%
Protocol code: 1378-0020
Sponsor: Boehringer Ingelheim International GmbH (Pharmaceutical company). Phase: Therapeutic confirmatory (Phase III). Countries: Netherlands (ongoing, recruiting), Italy (ongoing, recruiting), Romania (ongoing, recruiting), Poland (ongoing, recruiting), Germany (ongoing, recruiting), Belgium (ongoing, recruiting), Hungary (ongoing, recruiting), Spain (ongoing, recruiting), Czechia (ongoing, recruiting), Bulgaria (ongoing, recruiting), Slovenia (ongoing, recruiting).
Therapeutic area(s): Diseases [C] - Cardiovascular Diseases [C14]
Gender: Female, Male. Age: 18-64 years, 65+ years. Enrolment: 2632.
Status: Ongoing, recruiting. Start date (EU): 2024-10-18. Decision date: 2024-09-10. Results received: No. Last updated: 2026-07-01.
Decision dates by country: NL: 2024-09-23, ES: 2024-09-16, RO: 2024-09-23, IT: 2024-09-12, DE: 2024-09-30, PL: 2024-09-22, HU: 2024-09-17, BE: 2024-09-12, SI: 2024-11-25, BG: 2024-09-24, CZ: 2024-09-16

Condition(s): Heart failure (HF)
Product: Placebo matching BI 690517, EMPAGLIFLOZIN, BI 690517

Primary endpoint: The composite primary endpoint is the time to first event of CV death, HHF or urgent HF visit. CV death includes death of undetermined cause.
Endpoint(s): Time to first event of CV death or HHF., Occurrence of HHFs (first and recurrent)., Absolute change from baseline in KCCQ-TSS at Week 32.

Source: https://euclinicaltrials.eu/ctis-public/view/2023-509706-30-00